EU clinical trial 2024-517062-42-00: A prospective, multicenter, open-label, randomized, actively controlled, parallel-group Phase 3 clinical trial to evaluate efficacy, safety, and tolerability of IMA203 versus investigator’s choice of treatment in patients with previously treated, unresectable or metastatic cutaneous melanoma (ACTengine® IMA203-301)
Protocol code: IMA203-301
Sponsor: Immatics US Inc. (Pharmaceutical company). Phase: Therapeutic confirmatory (Phase III). Countries: Germany (ongoing, recruiting), France (ongoing, recruiting), Netherlands (authorised, recruitment pending).
Therapeutic area(s): Diseases [C] - Neoplasms [C04]
Gender: Female, Male. Age: 18-64 years, 65+ years. Enrolment: 108.
Start date (EU): 2025-05-02. Decision date: 2025-04-16. Results received: No. Last updated: 2026-07-23.
Decision dates by country: FR: 2026-04-20, DE: 2025-04-16, NL: 2026-04-13

Condition(s): melanoma, cutaneous malignant
Product: NIVOLUMAB, CARBOPLATIN, PACLITAXEL, PACLITAXEL ALBUMIN-BOUND, DACARBAZINE, IMA203, PEMBROLIZUMAB, IPILIMUMAB, Opdualag 240 mg/80 mg concentrate for solution for infusion, PEMBROLIZUMAB, NIVOLUMAB, TEMOZOLOMIDE, TEMOZOLOMIDE

Primary endpoint: Progression-free survival (PFS), centrally assessed by a Blinded Independent Central Review (BICR) using RECIST 1.1

Source: https://euclinicaltrials.eu/ctis-public/view/2024-517062-42-00